EU clinical trial 2024-519893-38-00: Phase Ib/II multicohort trial of different schemes of PM14 in monotherapy and in combination with radiotherapy in soft tissue sarcomas and other solid tumors
Sponsor: Asoc Grupo Espanol De Investigacion En Sarcomas (Patient organisation/association). Phase: Phase I and Phase II (Integrated)- Other. Countries: Spain (ongoing, recruitment ended).
Therapeutic area(s): Diseases [C] - Musculoskeletal Diseases [C05]; Diseases [C] - Neoplasms [C04]
Gender: Female, Male. Age: 18-64 years, 65+ years. Enrolment: 195.
Status: Ongoing, recruitment ended. Start date (EU): 2021-11-23. Decision date: 2024-12-19. Results received: No. Last updated: 2024-12-19.

Condition(s): Soft tissue sarcomas and other solid tumors
Product: PM14

Primary endpoint: COHORTS A AND B Phase I: The MTD will be determined by assessing adverse events according to CTCAE v5.0 and they will be used as a rule for escalating or diminishing dose levels according to the dose-limiting toxicities detailed in the protocol., COHORTS E AND F Phase II: PFSR-6m (according to central radiology review): Efficacy measured by the PFSR at 6 months, which is defined as the percentage of patients who did not experience radiological progression according to RECIST v1.1 or death due to any cause since the date of enrollment until month 6 after date of enrollment., COHORT C Phase I: The MTD will be determined by assessing adverse events according to CTCAE v5.0 and they will be used as a rule for escalating or diminishing dose levels according to the dose-limiting toxicities detailed in the protocol., COHORT C. Phase II: Overall response rate (ORR) (according to central radiology review): Efficacy measured by ORR, which is defined as the number of patients with a best overall response (BOR) of complete response (CR) or partial response (PR) divided by the number of response evaluable patients (according to RECIST v1.1). Only nodules included in the radiation field will be considered., COHORT D. Phase I: The MTD will be determined by assessing adverse events according to CTCAE v5.0 and they will be used as a rule for escalating or diminishing dose levels according to the dose -limiting toxicities detailed in the protocol., COHORT D. Phase II: Overall response rate (ORR) (according to central radiology review): Efficacy measured by ORR, which is defined as the number of patients with a best overall response (BOR) of complete response (CR) or partial response (PR) divided by the number of response evaluable patients (according to RECIST v1.1).
Endpoint(s): COHORTS A AND B. Phase I. Toxicity will be assessed by adverse events related to study drugs, detected through physical examinations and laboratory tests, and graded according to CTCAE v5.0., COHORTS A AND B. Phase I: Overall response rate (ORR) (according to central radiology review): Efficacy measured by ORR, which is defined as the number of patients with a best overall response (BOR) of complete response (CR) or partial response (PR) divided by the number of response evaluable patients (according to RECIST v1.1)., COHORTS A AND B. Phase I. mPFS (according to central radiology review): Efficacy measured by mPFS, which is defined as the median of time in months from date of enrollment to date of radiological progression according to RECIST v1.1 or to date of death due to any cause, whatever occurs first., COHORTS A AND B. Phase I: Quality of life: Assessed by using the EORTC QLQ-C30 questionnaire., COHORTS A AND B. Phase I: The clinical study will provide tumor and blood samples for the translational research program., COHORTS A AND B. Phase I: The clinical study will provide blood samples for the measurement of PM14 concentration and baseline α-1-acid glycoprotein (AAG) levels., COHORTS E AND F. Phase II: Overall response rate (ORR) (according to central radiology review): Efficacy measured by ORR, which is defined as the number of patients with a best overall response (BOR) of complete response (CR) or partial response (PR) divided by the number of response evaluable patients (according to RECIST v1.1)., COHORTS E AND F. Phase II: mOS: Efficacy measured by mOS, which is defined as the median of time in months from date of enrollment to date of death due to any cause. OS will be censored on the last date a patient was known to be alive., COHORTS E AND F. Phase II: Quality of life: Assessed by using the EORTC QLQ-C30 questionnaire., COHORTS E AND F. Phase II: Toxicity will be assessed by adverse events related to study drugs, detected through physical examinations and laboratory tests, and graded according to CTCAE v5.0., COHORTS E AND F. Phase II: The clinical study will provide tumor and blood samples for the translational research program., COHORT C. Phase I: Toxicity will be assessed by adverse events related to study drugs, detected through physical examinations and laboratory tests, and graded according to CTCAE v5.0., COHORT C. Phase I: Overall response rate (ORR) (according to central radiology review): Efficacy measured by ORR, which is defined as the number of patients with a best overall response (BOR) of complete response (CR) or partial response (PR) divided by the number of response evaluable patients (according to RECIST v1.1)., COHORT C. PHase I: Median of progression-free survival (mPFS) (according to central radiology review): Efficacy measured by mPFS, which is defined as the median of time in months from date of enrollment to date of radiological progression according to RECIST v1.1 or to date of death due to any cause, whatever occurs first., COHORT C. Phase I: Quality of life: Assessed by using the EORTC QLQ-C30 questionnaire., COHORT C. Phase I: The clinical study will provide tumor and blood samples for the translational research program., COHORT C. Phase II: Changes in pain: Variations in pain will be measured by the Brief Pain Inventory – Short Form (BPI-SF). (Further information in the protocol), COHORT C. Phase II: Changes in analgesic use: Variations in analgesic use will be measured by the Analgesic Quantification Algorithm (AQA). (More information in the protocol.), COHORT C. Phase II: Changes in quality of life measured by the QLQ-C30 EORTC v3.0 questionnaire. The proportions of patients showing little (5-10 points), moderate (11-20 points) or high changes (> 20) in pain and dyspnea (and other symptoms scales if applicable) over time. • The proportions of patients showing little (5-10 points), moderate (11-20 points) or high changes (> 20) in global health status scales over time., COHORT C. Phase II: Overall response rate (ORR) (according to central radiology review): Efficacy measured by ORR, which is defined as the number of patients with a best overall response (BOR) of complete response (CR) or partial response (PR) divided by the number of response evaluable patients (according to RECIST v1.1)., COHORT C. Phase II: Time to progression (TTP) of irradiated nodules (according to central radiology review): TTP is defined as the time in months between the date of enrollment and the date of progression of irradiated nodules (not including deaths) (according to RECIST v1.1 criteria)., COHORT C. Phase II: PFSR-6m (according to central radiology review): Efficacy measured by the PFSR at 6 months, which is defined as the percentage of patients who did not experience radiological progression according to RECIST v1.1 or death due to any cause since the date of enrollment until month 6 after date of enrollment., COHORT C. Phase II: mOS: Efficacy measured by mOS, which is defined as the median of time in months from date of enrollment to date of death due to any cause. OS will be censored on the last date a patient was known to be alive., COHORT C. Phase II: Pathological response: Assessed using a predefined surgical specimen pathology form and method describing the precise percentage of tumor non-viable histological changes (hyalinosis, necrosis, cyst, differentiation etc) and percentage of viable tumor., COHORT C. Phase II: Toxicity will be assessed by adverse events related to study drugs, detected through physical examinations and laboratory tests, and graded according to CTCAE v5.0., COHORT C. Phase II: The clinical study will provide tumor and blood samples for the translational research program., COHORT D. Phase I: Toxicity will be assessed by adverse events related to study drugs, detected through physical examinations and laboratory tests, and graded according to CTCAE v5.0., COHORT D. Phase I: Overall response rate (ORR) (according to central radiology review): Efficacy measured by ORR, which is defined as the number of patients with a best overall response (BOR) of complete response (CR) or partial response (PR) divided by the number of response evaluable patients (according to RECIST v1.1)., COHORT D. Phase I: Median of progression-free survival (mPFS) (according to central radiology review): Efficacy measured by mPFS, which is defined as the median of time in months from date of enrollment to date of radiological progression according to RECIST v1.1 or to date of death due to any cause, whatever occurs first., COHORT D. Phase I: Pathological response: Assessed using a predefined surgical specimen pathology form and method describing the precise percentage of tumor non-viable histological changes (hyalinosis, necrosis, cyst, differentiation etc) and percentage of viable tumor., COHORT D. Phase I: The clinical study will provide tumor and blood samples for the translational research program., COHORT D. Phase II: Pathological response: Assessed using a predefined surgical specimen pathology form and method describing the precise percentage of tumor non-viable histological changes (hyalinosis, necrosis, cyst, differentiation etc) and percentage of viable tumor., COHORT D. Phase II: Relapse-free survival (RFS) at 3 years: Efficacy measured by RFS at 3 years, which is defined as the percentage of patients who did not experience relapse since date of surgery until year 3 after date of surgery., COHORT D. Phase II: MRI imaging will be evaluated to assess variations in diffusion/perfusion parameters (exploratory)., COHORT D. Phase II: Toxicity will be assessed by adverse events related to study drugs, detected through physical examinations and laboratory tests, and graded according to CTCAE v5.0., COHORT D. Phase II: The clinical study will provide tumor and blood samples for the translational research program.

Source: https://euclinicaltrials.eu/ctis-public/view/2024-519893-38-00